EU clinical trial 2025-523087-20-00: A Phase 3, Randomized, Double-Blind, Placebo-Controlled, Global Study with an Open-Label Extension to Evaluate the Efficacy and Safety of Intravenous AOC 1044 (delpacibart zotadirsen) for the Treatment of DMD with Gene Mutations Amenable to Exon 44 Skipping
Protocol code: AOC 1044-CS3
Sponsor: Avidity Biosciences Inc. (Pharmaceutical company). Phase: Therapeutic confirmatory (Phase III). Countries: Italy (authorised, recruitment pending), Germany (ongoing, recruiting), France (authorised, recruitment pending), Spain (authorised, recruitment pending), Belgium (authorised, recruitment pending), Poland (authorised, recruitment pending), Netherlands (authorised, recruitment pending).
Therapeutic area(s): Diseases [C] - Musculoskeletal Diseases [C05]
Gender: Male. Age: 0-17 years. Enrolment: 42.
Start date (EU): 2026-07-28. Decision date: 2026-05-20. Results received: No. Last updated: 2026-05-27.
Decision dates by country: BE: 2026-05-20, FR: 2026-05-22, DE: 2026-05-20, IT: 2026-05-20, ES: 2026-05-25, PL: 2026-05-25, NL: 2026-05-27

Condition(s): Duchenne muscular dystrophy
Product: AOC 1044, Sodium Chloride 0.9% w/v

Primary endpoint: Change from baseline to Week 54 in TTR velocity
Endpoint(s): 1. Change from baseline to Week 54 as per protocol, 2.1 Change from Baseline as per protocol, 2.2 • Change from Baseline (all visits except Week 54) o creatine kinase o 4 stair climb velocity o 10mWRT velocity o SV95C o TTR velocity o NSAA o DMD-QoL o Patient/Caregiver Global Impression of Severity o QMT • Patient/Caregiver Global Impression of Change (all visits except Week 54), 3. • Incidence of TEAEs • Changes in vital signs • Changes in laboratory parameters • Changes in ECGs

Source: https://euclinicaltrials.eu/ctis-public/view/2025-523087-20-00